EU clinical trial 2025-521196-32-00: Phase III, randomized, open-label, single-site clinical trial to evaluate the efficacy and safety of enoxaparin as a prophylactic treatment for localized intravascular coagulopathy and the impact of endothelial damage markers in patients aged 0 to 18 years with slow-flow vascular malformations undergoing percutaneous interventional procedures (PEaRL-X)
Protocol code: FSJD-PEaRL-X-2025
Sponsor: Fundacio Sant Joan De Deu (Patient organisation/association). Phase: Therapeutic confirmatory (Phase III). Countries: Spain (ongoing, recruiting).
Therapeutic area(s): Diseases [C] - Hemic and Lymphatic Diseases [C15]
Gender: Female, Male. Age: 0-17 years, 18-64 years. Enrolment: 60.
Status: Ongoing, recruiting. Start date (EU): 2025-09-12. Decision date: 2025-07-22. Results received: No. Last updated: 2026-01-26.

Condition(s): Venous malformation or low-flow venous/lymphatic malformation
Product: Enoxaparina Rovi 4.000 UI (40 mg)/0,4 ml solución inyectable en jeringa precargada, Enoxaparina Rovi 2.000 UI (20 mg)/0,2 ml solución inyectable en jeringa precargada, Enoxaparina Rovi 10.000 UI (100 mg)/1 ml solución inyectable en jeringa precargada, Enoxaparina Rovi 6.000 UI (60 mg)/0,6 ml solución inyectable en jeringa precargada, Enoxaparina Rovi 8.000 UI (80 mg)/0,8 ml solución inyectable en jeringa precargada

Primary endpoint: 1. Values of localized intravascular coagulopathy and endothelial damage in patients receiving/not receiving prophylactic treatment with enoxaparin., 2. Hemorrhagic clinical signs related to treatment through: • Subjective assessment of bleeding • Hemoglobin levels • Classification of haemorrhage
Endpoint(s): 1. Baseline analytical parameters of localized intravascular coagulopathy and endothelial damage., 2. Values of localized intravascular coagulopathy (D-dimer, fibrinogen, platelets) in relation to possible risk factors: age, characteristics and extent of the malformation, genetic diagnosis, and bone/muscular/visceral involvement., 3. Analytical parameters of localized intravascular coagulopathy and endothelial damage in relation to the degree of inflammation, pain presented by patients after the intervention, appearance of new phleboliths, or development of deep vein thrombosis during the study period.

Source: https://euclinicaltrials.eu/ctis-public/view/2025-521196-32-00